EU clinical trial 2023-504246-64-02: A phase I/II trial of ABTL0812 in children with relapsed/refractory neuroblastoma and other solid tumours
Protocol code: ETNA
Sponsor: Fir Huvh Fundacio Institut De Recerca Hospital Universitari Vall De Hebron (Laboratory/Research/Testing facility). Phase: Phase I and Phase II (Integrated)- Other. Countries: Spain (ongoing, recruiting).
Therapeutic area(s): Diseases [C] - Neoplasms [C04]
Gender: Female, Male. Age: 0-17 years, 18-64 years. Enrolment: 48.
Status: Ongoing, recruiting. Start date (EU): 2025-06-04. Decision date: 2024-11-12. Results received: No. Last updated: 2026-03-30.

Condition(s): Relapsed/refractory neuroblastoma and other solid tumours
Product: ABTL0812, IRINOTECAN, TEMOZOLOMIDE

Primary endpoint: Incidence of dose limiting toxicities assessed during the first cycle of study treatment of ABTL0182 (cohorts A and B).

Source: https://euclinicaltrials.eu/ctis-public/view/2023-504246-64-02